EU clinical trial 2024-519218-30-00: A Phase 3, Double-Blind, Placebo-Controlled, Multicenter Clinical Study comparing Chemo-Immunotherapy (Paclitaxel-Carboplatin-Oregovomab) versus Chemotherapy (Paclitaxel-Carboplatin-Placebo) in Patients with Advanced Epithelial Ovarian, Fallopian Tube or Peritoneal Carcinoma
Protocol code: QPT-ORE-005
Sponsor: Canariabio Inc. (Pharmaceutical company). Phase: Therapeutic confirmatory (Phase III). Countries: Hungary (ongoing, recruitment ended), Spain (ongoing, recruitment ended), Belgium (ongoing, recruitment ended), Czechia (ongoing, recruitment ended), Italy (ongoing, recruitment ended).
Therapeutic area(s): Diseases [C] - Neoplasms [C04]
Gender: Female. Age: 18-64 years, 65+ years. Enrolment: 64.
Status: Ongoing, recruitment ended. Start date (EU): 2021-05-26. Decision date: 2024-11-20. Results received: No. Last updated: 2025-12-01.
Decision dates by country: CZ: 2024-11-27, HU: 2024-11-20, ES: 2024-11-20, BE: 2024-11-22, IT: 2025-01-10

Condition(s): Advanced epithelial ovarian, fallopian tube or peritoneal carcinoma
Product: Powder for solution for infusion, Oregovomab

Primary endpoint: PFS, defined as date of randomization which occurs following surgery to the date of event defined as the first documented progression as per RECIST v1.1 as determined by the investigator or death due to any cause
Endpoint(s): OS, defined as date of randomization to date of death due to any cause, Incidence of adverse events (AEs) – including AEs, serious AEs (SAEs), deaths, and AEs leading to discontinuation of treatment, frequency/ severity of vital signs measurements, physical examination findings, and changes in clinical laboratory parameters (haematology, biochemistry, urinalysis), Change from baseline in the global health status/QOL scale score of the Functional Assessment of Cancer Therapy-Ovary (FACT-O TOI) and 3 additional questions from the NFOSI-18 in each treatment group.

Source: https://euclinicaltrials.eu/ctis-public/view/2024-519218-30-00